EU clinical trial 2024-514952-34-00: Randomized open-label controlled trial evaluating a single-dose intravenous Dalbavancin versus standard antibiotic therapy during catheterrelated bloodstream infections due to Staphylococcus aureus [DALICATH]
Protocol code: APHP220763
Sponsor: Assistance Publique Hopitaux De Paris (Hospital/Clinic/Other health care facility). Phase: Therapeutic confirmatory (Phase III). Countries: France (ongoing, recruiting).
Therapeutic area(s): Diseases [C] - Bacterial Infections and Mycoses [C01]
Gender: Female, Male. Age: 18-64 years, 65+ years. Enrolment: 406.
Status: Ongoing, recruiting. Start date (EU): 2023-06-23. Decision date: 2024-09-12. Results received: No. Last updated: 2026-07-30.

Condition(s): Catheter related bloodstream infections due to Staphylococcus aureus
Product: GENTAMICIN, PIPERACILLIN AND BETA-LACTAMASE INHIBITOR, SULFAMETHOXAZOLE AND TRIMETHOPRIM, AMOXICILLIN, CEFOTAXIME, CEFTAROLINE FOSAMIL, CIPROFLOXACIN, CLINDAMYCIN, Xydalba 500 mg powder for concentrate for solution for infusion, VANCOMYCIN, DAPTOMYCIN, RIFAMPICIN, DOXYCYCLINE, AMIKACIN, LINEZOLID, DELAFLOXACIN, PRISTINAMYCIN, LYMECYCLINE, OXACILLIN, CLOXACILLIN, TEICOPLANIN, TEDIZOLID, AMOXICILLIN AND BETA-LACTAMASE INHIBITOR, CEFAZOLIN, LEVOFLOXACIN, TIGECYCLINE, CEFTRIAXONE, OFLOXACIN

Primary endpoint: Clinical cure without relapse at Day 30, defined by the absence of all the following: Local and/or general signs of infection, Relapse of bacteremia to S. aureus ; In dalbavancin arm: Any additional antibiotic therapy active on S. aureus received between DAY 0 and DAY 14 - In both arms: Any additional antibiotic therapy active on S. aureus received after DAY 14; i.e. between DAY 14 and DAY 30, Deep focus infection including endocarditis, Death from all causes
Endpoint(s): Clinical cure at DAY 14 and DAY 90 (EOS), Death all-cause occurring within 90 days of follow-up, Time from first positive blood culture to first negative blood cultures (in days), limited to DAY 14, Autonomy, pain and anxiety using EQ-5D-5L scale at baseline (Day 0), DAY 14, DAY 30 and DAY 90 (EOS), Hospitalization duration in days, Cost per avoided relapse, life-year gained, and per quality-adjusted life year (QALY), Proportion of patients with any adverse event until EOS. It includes the complications due to venous catheterization

Source: https://euclinicaltrials.eu/ctis-public/view/2024-514952-34-00